EU clinical trial 2022-502269-13-00: I3Y-MC-JPEH: A Randomized, Open-Label, Phase 2 Study Evaluating Abemaciclib in Combination With Temozolomide Compared to Temozolomide Monotherapy in Children and Young Adults With Newly Diagnosed High-Grade Glioma Following Radiotherapy.
Protocol code: I3Y-MC-JPEH
Sponsor: Eli Lilly & Co. (Pharmaceutical company). Phase: Therapeutic exploratory (Phase II). Countries: Spain (ongoing, recruitment ended), Belgium (ongoing, recruitment ended), France (ongoing, recruitment ended), Italy (ongoing, recruitment ended), Denmark (ongoing, recruitment ended), Romania (ongoing, recruitment ended), Netherlands (ongoing, recruitment ended).
Therapeutic area(s): Diseases [C] - Neoplasms [C04]
Gender: Female, Male. Age: 0-17 years, 18-64 years. Enrolment: 30.
Status: Ongoing, recruitment ended. Start date (EU): 2024-09-24. Decision date: 2024-08-05. Results received: No. Last updated: 2026-05-15.
Decision dates by country: RO: 2025-03-17, NL: 2025-04-24, DK: 2025-02-21, IT: 2024-08-12, BE: 2024-08-06, FR: 2024-08-05, ES: 2024-08-09

Condition(s): Glioma
Product: Abemaciclib, Abemaciclib, Verzenios 50 mg film-coated tablets, TEMOZOLOMIDE

Primary endpoint: Event Free Survival as Determined by Blinded Independent Review Committee

Source: https://euclinicaltrials.eu/ctis-public/view/2022-502269-13-00